EU clinical trial 2024-512004-19-01: The NIPA study: A randomized double-blind control clinical trial Naloxegol administration to prevent opioids induced gastrointestinal motility disturbance in brain Injured PAtients.
Protocol code: 2019-000959-14
Sponsor: Centre Hospitalier Regional Et Universitaire De Brest (Hospital/Clinic/Other health care facility). Phase: Therapeutic confirmatory (Phase III). Countries: France (ongoing, recruiting).
Therapeutic area(s): Diseases [C] - Pathological Conditions, Signs and Symptoms [C23]
Gender: Female, Male. Age: 18-64 years, 65+ years. Enrolment: 370.
Status: Ongoing, recruiting. Start date (EU): 2024-07-02. Decision date: 2024-07-02. Results received: No. Last updated: 2025-09-11.

Condition(s): Head trauma, Meningeal hemorrhage, Gastrointestinal motility disorders
Product: Moventig 25 mg film-coated tablets, Placebo of Moventif 25mg

Primary endpoint: Composite criterion defined by the occurrence of one of the following events: - Absence of bowel movements before D6 of hospitalisation - Incidence of VAP before D7 of hospitalisation
Endpoint(s): Proportion of patient-days achieving the theoretical caloric objective of enteral nutrition (≥25 Kcal/kg/day), Number of patients requiring erythromycin and/or metoclopramide at least once for vomiting during enteral feeding, Number of patients who received at least one rectal laxative for constipation, Time in days to first bowel movement (in case of delayed constipation), Number of patients with late VAP (after 7 days of invasive mechanical ventilation), Number of days without invasive mechanical ventilation, Length of stay in intensive care unit, GOSE score (Glasgow Outcome Scale Extended) at 6 months, Number of patients with an episode of HTIC requiring further sedation, targeted temperature control, introduction of barbiturates, or decompression craniectomy.

Source: https://euclinicaltrials.eu/ctis-public/view/2024-512004-19-01